EU clinical trial 2023-504304-29-00: A Study to Evaluate Safety, Pharmacokinetics and Pharmacodynamics of Selnoflast in Participants with Moderate to Severe Asthma
Protocol code: BP44551
Sponsor: F. Hoffmann-La Roche AG (Pharmaceutical company). Phase: Human Pharmacology (Phase I)- Other. Countries: Belgium (ended), Netherlands (ended), Germany (ended).
Therapeutic area(s): Diseases [C] - Immune System Diseases [C20]
Gender: Female, Male. Age: 18-64 years, 65+ years. Enrolment: 30.
Status: Ended. Start date (EU): 2024-03-01. End date (EU): 2025-11-13. End date: 2025-11-14. Decision date: 2024-01-22. Results received: No. Last updated: 2025-09-15.
Decision dates by country: BE: 2024-01-22, NL: 2024-02-13, DE: 2024-01-25

Condition(s): Moderate to Severe Asthma

Source: https://euclinicaltrials.eu/ctis-public/view/2023-504304-29-00